EU clinical trial 2025-522287-32-00: A randomised, double-blind, placebo-controlled phase Ib trial evaluating the safety, tolerability, pharmacokinetics and pharmacodynamics of single and multiple doses of ACD856 in healthy participants
Sponsor: AlzeCure Pharma AB (Pharmaceutical company). Phase: Human Pharmacology (Phase I)- Other. Countries: Sweden (ended).
Therapeutic area(s): Psychiatry and Psychology [F] - Mental Disorders [F03]; Diseases [C] - Nervous System Diseases [C10]
Gender: Female, Male. Age: 18-64 years, 65+ years. Enrolment: 40.
Status: Ended. Start date (EU): 2025-10-22. End date (EU): 2026-04-09. Decision date: 2025-09-10. Results received: No. Last updated: 2025-09-10.

Condition(s): Depression, Cognitive dysfunction, Alzheimer’s disease

Source: https://euclinicaltrials.eu/ctis-public/view/2025-522287-32-00